EU clinical trial 2024-520208-25-00: An open-label phase II trial to evaluate the clinical efficacy, safety and tolerability of MAS825 in pediatric and adult participants with Still’s disease
Protocol code: CMAS825J12201
Sponsor: Novartis Pharma AG (Pharmaceutical company). Phase: Therapeutic exploratory (Phase II). Countries: Italy (ongoing, recruiting), Netherlands (ongoing, recruiting), Spain (ongoing, recruiting), France (ongoing, recruiting), Germany (ongoing, recruiting).
Therapeutic area(s): Diseases [C] - Immune System Diseases [C20]
Gender: Female, Male. Age: 0-17 years, 18-64 years, 65+ years. Enrolment: 15.
Status: Ongoing, recruiting. Start date (EU): 2026-01-15. Decision date: 2025-10-28. Results received: No. Last updated: 2026-03-06.
Decision dates by country: FR: 2025-11-03, DE: 2025-10-29, NL: 2025-10-28, ES: 2025-10-29, IT: 2025-10-28

Condition(s): Still’s disease
Product: MAS825

Primary endpoint: Clinical response defined by achieving a composite endpoint
Endpoint(s): Adverse events and serious adverse events. Safety measures including vital signs, ECG and laboratory assessments throughout the study, Clinical response defined by achieving a composite endpoint, Change in physician´s assessment. Change in laboratory features of Macrophage Activation Syndrome, Glucocorticoid dose compared to baseline, Change from baseline in patient/parent assessment of physical function, Clinically inactive disease whilst on non‑treatment dose corticosteroid at any time during the study

Source: https://euclinicaltrials.eu/ctis-public/view/2024-520208-25-00